EU clinical trial 2024-516852-17-00: Clinical trial of (+)-α-dihydrotetrabenazine in patients with moderate to severe tardive dyskinesia with open-label Part I and randomized, double-blind, placebo-controlled Part II.
Protocol code: ADT-2022-003
Sponsor: Adeptio Pharmaceuticals Limited (Pharmaceutical company). Phase: Therapeutic exploratory (Phase II). Countries: Hungary (authorised, recruitment pending), Czechia (authorised, recruiting), Slovakia (authorised, recruitment pending), Poland (authorised, recruitment pending).
Therapeutic area(s): Diseases [C] - Nervous System Diseases [C10]
Gender: Female, Male. Age: 18-64 years, 65+ years. Enrolment: 102.
Start date (EU): 2023-11-13. Decision date: 2024-09-25. Results received: No. Last updated: 2026-08-06.
Decision dates by country: SK: 2024-09-30, PL: 2024-10-13, HU: 2024-09-25, CZ: 2024-09-26

Condition(s): Tardive dyskinesia
Product: ADE513 placebo, (+)-α-DIHYDROTETRABENAZINE

Primary endpoint: Change in AIMS score (items 1 through 7) from Baseline (Day 0) to Week 12, as assessed by central rating.
Endpoint(s): Part I Secondary Endpoints: - Change in AIMS score (items 1 through 7) from Baseline (Day 0) to Week 12) in Part I, as assessed by the on-site Investigator. - Change in AIMS score (items 1 through 7 from Baseline (Day 0) to Week 9 in Part I, as assessed by the on-site Investigator. - Change in AIMS score (items 1 through 7) from Week 6 to Week 12 in Part I, as assessed by the on-site Investigator., Part II Secondary Endpoints: - Dose level associated with adequate control of dyskinesia (defined as dose level used in Maintenance period) in Part II. - Proportion of subjects with the value of Much or Very Much Improved on the Clinical Global Impression of Change (CGIC) at Week 12 in Part II. - Proportion of subjects with the value of Much or Very Much Improved on the Patient Global Impression of Change (PGIC) at Week 12 in Part II.

Source: https://euclinicaltrials.eu/ctis-public/view/2024-516852-17-00